EU clinical trial 2023-506617-21-00: A randomised, controlled trial to investigate the effect of a six-week intensified pharmacological treatment for major depressive disorder compared to treatment as usual in subjects who had a first-time treatment failure on their first-line treatment.
Protocol code: INTENSIFY MDD
Sponsor: Universitair Medisch Centrum Utrecht (Hospital/Clinic/Other health care facility). Phase: Therapeutic confirmatory (Phase III). Countries: Germany (ongoing, recruiting), Italy (ongoing, recruiting), Spain (ongoing, recruiting), Austria (ongoing, recruiting), Greece (authorised, recruitment pending).
Therapeutic area(s): Psychiatry and Psychology [F] - Mental Disorders [F03]
Gender: Female, Male. Age: 18-64 years. Enrolment: 360.
Start date (EU): 2024-08-29. Decision date: 2024-01-17. Results received: No. Last updated: 2026-07-30.
Decision dates by country: AT: 2024-01-22, DE: 2024-01-17, IT: 2024-01-19, ES: 2024-01-22, GR: 2024-12-04

Condition(s): Major depressive disorder
Product: TIANEPTINE, ESKETAMINE, NORTRIPTYLINE, IMIPRAMINE, ESCITALOPRAM, DULOXETINE, SERTRALINE, AMITRIPTYLINE, FLUOXETINE, KETAMINE, VENLAFAXINE, MIANSERIN, MIRTAZAPINE, FLUVOXAMINE, TRAZODONE, CITALOPRAM, ATOMOXETINE, AGOMELATINE, PAROXETINE, ESKETAMINE, REBOXETINE, BUPROPION, DOSULEPIN, DESVENLAFAXINE, MILNACIPRAN, CLOMIPRAMINE, VORTIOXETINE

Primary endpoint: Mean change from baseline (visit 2) in symptom severity as measured by the MADRS total score at six weeks (visit 4) will be compared between the two treatment arms (EIPT vs. TAU) for the lines of treatment separately (subgroup analysis wherein the focus will be on participants who had a first time treatment failure on their first-line treatment) and for the group as a whole (irrespective of line of treatment).
Endpoint(s): 1.a. Change from baseline (visit 2) in the severity sub-score of the Clinical Global Impression Scale (CGI) at visit 4; EIPT vs TAU. 1.b. Improvement sub-score of the Clinical Global Impression Scale (CGI) at visit 4; EIPT vs TAU., Changes from baseline (visit 2) in total Hospital Anxiety and Depression Scale (HADS) total score and anxiety and depression subscales at visit 4; EIPT vs TAU., Change from baseline (visit 2) in quality of life and functioning measures (Q-LES-Q-SF, LAPS, QLS-100 and SDS ) at visit 4; EIPT vs TAU., Changes from baseline (visit 2) on Trail Making Test, Digit Symbol Substitution Test, Rey Auditory Verbal Learning Test as well as the Perceived Deficits Questionnaire at visit 4; EIPT vs TAU., Presence of symptomatic remission at visit 4; EIPT vs TAU. Remission is defined as a MADRS score ≤ 12., Presence of reported side effects as measured through General Assessment of Side Effects Scale (GASE) and reported spontaneously throughout the studyat visit 4; EIPT vs TAU., Concomitant medication use throughout the studyat visit 4; EIPT vs TAU., Premature treatment discontinuation before visit 4 and time to treatment discontinuation and reported reason of discontinuation; EIPT vs TAU., Changes on the Columbia-Suicide Severity Rating Scale (C-SSRS) throughout the study; EIPT vs TAU

Source: https://euclinicaltrials.eu/ctis-public/view/2023-506617-21-00